EU clinical trial 2022-501234-37-00: A Phase 1/2 Study of REGN7075 (EGFRxCD28 Costimulatory Bispecific Antibody) in Combination with Cemiplimab in Patients with Advanced Solid Tumors
Protocol code: R7075-ONC-2009
Sponsor: Regeneron Pharmaceuticals Inc. (Pharmaceutical company). Phase: Phase I and Phase II (Integrated)- First administration to humans. Countries: Spain (ongoing, recruitment ended), France (ongoing, recruitment ended), Netherlands (ongoing, recruitment ended), Poland (ongoing, recruitment ended).
Therapeutic area(s): Diseases [C] - Neoplasms [C04]
Gender: Female, Male. Age: 18-64 years, 65+ years. Enrolment: 212.
Status: Ongoing, recruitment ended. Start date (EU): 2024-05-07. Decision date: 2023-08-23. Results received: No. Last updated: 2026-04-22.
Decision dates by country: NL: 2024-11-07, PL: 2024-11-11, FR: 2023-08-24, ES: 2023-08-23

Condition(s): Solid Tumours
Product: Pemetrexed EVER Pharma 25 mg/ml Konzentrat zur Herstellung einer Infusionslösung, LIBTAYO 350 mg concentrate for solution for infusion., REGN7075, REGN7075, LIBTAYO 350 mg concentrate for solution for infusion., Paclitaxel AqVida 6 mg/ml Konzentrat zur Herstellung einer Infusionslösung, Cisplatinum Accord, 1 mg/ml, koncentrat do sporządzania roztworu do infuzji., Lonsurf 20 mg/8.19 mg film-coated tablets, Carboplatin Hikma 10 mg/ml Konzentrat zur Herstellung einer Infusionslösung, Avastin 25 mg/ml concentrate for solution for infusion., LIBTAYO 350 mg concentrate for solution for infusion., LIBTAYO 350 mg concentrate for solution for infusion., Lonsurf 15 mg/6.14 mg film-coated tablets, Pemetrexed Fresenius Kabi 25 mg/ml concentrate for solution for infusion

Primary endpoint: Dose escalation: The incidence of dose-limiting toxicities (DLTs) during the DLT period, Dose escalation: Incidence and severity of treatment emergent adverse events (TEAEs), Dose escalation: Incidence and severity of adverse events of special interest (AESIs), Dose escalation: Incidence and severity of serious adverse events (SAEs), Dose escalation: Incidence and severity of grade ≥3 laboratory abnormalities, Dose expansion: Objective Response Rate (ORR)
Endpoint(s): Dose escalation and dose expansion: Concentrations of marlotamig in serum, Dose escalation: ORR, Dose escalation and dose expansion: Progression free survival (PFS), Dose escalation and dose expansion: Duration of Response (DOR), Dose escalation and dose expansion: Disease control rate (DCR), Dose escalation and dose expansion: Complete response (CR) rate, Dose escalation and dose expansion: Overall survival (OS), Dose escalation and dose expansion: Incidence of anti-drug antibodies (ADA) to marlotamig, Dose escalation and dose expansion: Magnitude of ADA to marlotamig, Dose escalation and dose expansion: Incidence of ADA to cemiplimab, Dose escalation and dose expansion: Magnitude of ADA to cemiplimab, Dose expansion: The incidence and severity of TEAEs, Dose expansion: The incidence and severity of AESIs, Dose expansion: The incidence and severity of SAEs, Dose expansion: The incidence and severity of grade ≥3 laboratory abnormalities, Dose expansion: Patient reported QoL, symptoms, functioning and general health status (per EORTC QLQ-C30, EORTC QLQ-CR29 in CRC patients, EORTC QLQ-BR23 in breast cancer patients, EORTC QLQ-LC13 in NSCLC patients, EORTC QLQ-HN35 in HNSCC patients, and EQ-5D-5L).

Source: https://euclinicaltrials.eu/ctis-public/view/2022-501234-37-00